EU clinical trial 2025-522234-31-00: The bioavailability study of Dapagliflozin
Sponsor: Laboratorios Cinfa S.A. (Pharmaceutical company). Phase: Human Pharmacology (Phase I)- Bioequivalence Study. Countries: Czechia (ended).
Therapeutic area(s): Diseases [C] - Nutritional and Metabolic Diseases [C18]; Diseases [C] - Cardiovascular Diseases [C14]
Gender: Female, Male. Age: 18-64 years. Enrolment: 32.
Status: Ended. Start date (EU): 2025-08-20. End date (EU): 2025-09-18. Decision date: 2025-08-06. Results received: No. Last updated: 2025-08-29.

Condition(s): not applicable (submitted trial is a bioequivalence study

Source: https://euclinicaltrials.eu/ctis-public/view/2025-522234-31-00